EU clinical trial 2024-518138-10-00: Analysis of the efficacy and safety of two combination treatment regimens of nivolumab and ipilimumab in patients with dMMR and / or MSI metastatic colorectal cancer: A GERCOR open-label, randomized, non-comparative, two-stage phase II trial (NIPISAFE)
Protocol code: NIPISAFE G-106
Sponsor: Association Gercor (Laboratory/Research/Testing facility). Phase: Therapeutic exploratory (Phase II). Countries: France (authorised, recruitment pending).
Therapeutic area(s): Diseases [C] - Digestive System Diseases [C06]
Gender: Female, Male. Age: 18-64 years, 65+ years. Enrolment: 93.
Status: Authorised, recruitment pending. Decision date: 2025-01-09. Results received: No. Last updated: 2026-05-11.

Condition(s): Patients with DMMR and/or MSI metastatic colorectal cancer
Product: YERVOY 5 mg/ml concentrate for solution for infusion, OPDIVO 10 mg/mL concentrate for solution for infusion.

Primary endpoint: The co-primary endpoint of this study is Grade 3 or 4 TRAEs during the first 24 weeks (NCI CTCAE v5.0) and PFS at week 24
Endpoint(s): AEs (NCI CTCAE v5.0), Treatment and iAEs, Percentage of patients who received immune modulating concomitant medication (e.g., corticosteroids, infliximab, mycophenolate mofetil), Percentage of patients who received hormonal replacement therapy for immune-related endocrine toxicities, Median time to onset, median time to resolution of SAEs and TRAEs (grade 3-4), Score changes in EORTC QLQ-C30 and NCI-PRO-CTCAE scales, ORR at weeks 24 and 48, and at 2 years (RECIST v1.1), PFS at week 48 and at 2 years (RECIST v1.1), PFS and ORR at weeks 24 and 48, and at 2 years (iRECIST), OS at weeks 24 and 48, and at 2 years

Source: https://euclinicaltrials.eu/ctis-public/view/2024-518138-10-00